EU clinical trial 2024-519968-41-00: Efficacy of simvastatin reducing liver fibrosis in patients with advanced fibrosis due to alcohol: a randomized, double-blind, placebo-controlled clinical trial.
Protocol code: SIMFIB
Sponsor: Fundacio De Recerca Clinic Barcelona-Institut D’Investigacions Biomediques August Pi I Sunyer (Laboratory/Research/Testing facility). Phase: Phase II and Phase III (Integrated). Countries: Spain (ongoing, recruiting).
Therapeutic area(s): Diseases [C] - Digestive System Diseases [C06]
Gender: Female, Male. Age: 18-64 years, 65+ years. Enrolment: 90.
Status: Ongoing, recruiting. Start date (EU): 2024-12-11. Decision date: 2024-12-11. Results received: No. Last updated: 2024-12-11.

Condition(s): Fibrosis liber, chronic liver disease, alcoholic liver disease
Product: Placebo, Simvastatina NORMON 40 mg comprimidos recubiertos con película EFG

Primary endpoint: Change from baseline biopsy in the histological fibrosis score measured using the Ishak scale at 24 months.
Endpoint(s): 1. Analyze the effect of simvastatin on liver fibrosis evaluated by noninvasive methods: a. Change in liver elasticity measured by transient liver elastography at 6, 12, 18 and 24 months. b. Change in liver elasticity measured by ERM at 24 months., 1.c. Changes in serum markers and liver fibrosis scores validated for ALD and widely used in the general population: FIB-4 (Fibrosis Index for Liver Fibrosis) and ELF (Enhanced liver Fibrosis), pro-collagen 3, hydroxyproline, metalloproteinase 1 and telopeptide, at 6, 12, 18 y 24 months., 2. Study the changes in liver fibrosis and other histological parameters of the disease: a. Absence of progression compared to the baseline biopsy in the histological fibrosis score measured using the Ishak scale at 24 months. b. Shift in the degree of liver fibrosis measured using the Ishak scale, estimated with ordinal analysis., 2.c. Changes in liver fibrosis evaluated using the Metavir scale (including the shift evaluated with ordinal analysis), the EPOS scale, and the "7-tier fibrosis staging system for ALD" at 24 months. d. Change in the collagen proportional area in liver biopsies stained with Sirius red and analyzed with Image J software at 24 months. e. Changes in histological parameters of chronic alcoholic liver disease: steatosis, neutrophil infiltration, Mallory bodies, etc., at 24 months., 3. Changes in the diversity and taxonomic composition of the gut microbiota through massive sequencing, at 24 months of treatment., 4. Analyze the markers of systemic inflammation, immune response, bacterial translocation, and endothelial dysfunction: a. Change in the levels of pro-inflammatory cytokines associated with alcoholic liver disease: IL-6, TNFα, and procalcitonin; at 6, 12, 18, and 24 months. b. Change in the levels of bacterial translocation markers: bacterial lipopolysaccharide and lipopolysaccharide-binding protein; at 6, 12, 18, and 24 months., 4.c. Change in the levels of endothelial dysfunction markers: nitric oxide (NO), von Willebrand factor (vWF); at 6, 12, 18, and 24 months. d. Change in the inflammatory profile of circulating immune cells: lymphocytes, monocytes, and neutrophils; at 24 months., 5. Analyze the polymorphisms of the SLCO1B1 gene and their relationship with muscle toxicity., 6. Incidence of adverse effects and safety of the treatment.

Source: https://euclinicaltrials.eu/ctis-public/view/2024-519968-41-00